EU clinical trial 2023-507597-40-00: A PHASE I/II STUDY TO INVESTIGATE THE SAFETY AND FEASIBILITY OF POINT-OF-CARE HUMAN-CD19 TARGETING CAR T-CELLS IN PAEDIATRIC AND YOUNG ADULT PATIENTS WITH RELAPSED OR REFRACTORY B-CELL MALIGNANCIES (PACMAN)
Protocol code: SP_MB21PAC
Sponsor: Prinses Maxima Centrum voor Kinderoncologie B.V. (Hospital/Clinic/Other health care facility). Phase: Phase I and Phase II (Integrated)- Other. Countries: Netherlands (authorised, recruitment pending).
Therapeutic area(s): Diseases [C] - Neoplasms [C04]
Gender: Female, Male. Age: 0-17 years, 18-64 years. Enrolment: 18.
Status: Authorised, recruitment pending. Decision date: 2025-12-16. Results received: No. Last updated: 2026-01-12.

Condition(s): B-cell precursor ALL, B-cell Non Hodgkin Lymphoma
Product: MB-huCART19.1

Primary endpoint: Dose at which ≤ 1 patients experience a Dose Limiting Toxicity (DLT) within 28 days after CAR T-cell infusion
Endpoint(s): For B-ALL: the MRD-negative CR rate at day 28, For B-NHL: the overall response rate (ORR, CR +PR according to Lugano criteria) at day 90, Surrogate endpoint for efficacy: B-cell aplasia (<5 B-cells/µl) at day 28 after infusion, Number of days until relapse, Number of days from CAR T-cell infusion until recovery of B-cells (B-cell recovery is defined as peripheral blood ≥10 CD19+ B-cells/mcL OR ≥1% CD19+ B-cells in the bone marrow. Results must be confirmed on a subsequent test ≥2 weeks apart with timing of B-cell recovery defined as the date of the initial sample, Event free survival (EFS) at 6 and 12 months, Overall Survival (OS) at 6 and 12 months, Cumulative Incidence of Relapse at 6 and 12 months, The percentage of products fulfilling the release criteria

Source: https://euclinicaltrials.eu/ctis-public/view/2023-507597-40-00